EU clinical trial 2025-520496-19-00: Clinical and economical efficiency and safety and inflammation parameter correlations study of conservative treatment of non-complicated acute appendicitis in 7 to 18 years old children.
Sponsor: Riga Stradins University (Educational Institution). Phase: Therapeutic use (Phase IV). Countries: Latvia (authorised, recruitment pending).
Therapeutic area(s): Diseases [C] - Digestive System Diseases [C06]
Gender: Female, Male. Age: 0-17 years. Enrolment: 60.
Status: Authorised, recruitment pending. Decision date: 2025-01-30. Results received: No. Last updated: 2025-01-30.

Condition(s): Acute non-complicated appendicitis in patients aged 7 to 18
Product: Amoksiklav 875 mg/125 mg apvalkotās tabletes, Metronidazole Unifarma 5 mg/ml škidums infuzijam, Medoclav 500 mg/125 mg apvalkotās tabletes, Pamecil 1 g pulveris injekciju/infūziju šķīduma pagatavošanai, Ceftazidime Fresenius Kabi 1000 mg pulveris injekciju šķīduma pagatavošanai

Primary endpoint: 3 days in-patient treatment; 7 days out-patient treatment
Endpoint(s): 1 month follow-up; 1 year follow-up

Source: https://euclinicaltrials.eu/ctis-public/view/2025-520496-19-00